EU clinical trial 2023-505385-28-00: Prospective biomarker analysis in HR+/HER2- advanced or metastatic breast cancer patients treated with sacituzumab govitecan (ACROSS-TROP2)
Protocol code: SOLTI-2201
Sponsor: Solti Group (Pharmaceutical company). Phase: Therapeutic exploratory (Phase II). Countries: Spain (ongoing, recruitment ended).
Therapeutic area(s): Diseases [C] - Neoplasms [C04]
Gender: Female, Male. Age: 18-64 years, 65+ years. Enrolment: 100.
Status: Ongoing, recruitment ended. Start date (EU): 2023-10-19. Decision date: 2023-09-22. Results received: No. Last updated: 2026-08-04.

Condition(s): male or pre/post-menopausal women age ≥ 18 years with locally advanced/metastatic HR+/HER2-negative BC resistant to ET + CDK4/6 inhibitors. No more than 1 prior systemic chemotherapy or ADC regimens for metastatic disease are permitted.
Product: Trodelvy 200 mg powder for concentrate for solution for infusion

Primary endpoint: Mean change in CelTIL score per central assessment between paired baseline and C2D1(14-21 days after treatment initiation) tumor samples in the overall population. CelTIL score = -0.8 x tumor cellularity (%) + 1.3 x tumor-infiltrating lymphocytes (TILs) (%). The minimum and maximum unscaled CelTIL scores will be −80 and 130. This unscaled CelTIL score will then be scaled to reflect a range from 0 to 100 points.
Endpoint(s): Overall Response Rate (ORR) defined as the proportion of patients with measurable disease with best overall response of complete response (CR) or partial response (PR), as per local investigator´s assessment and according to Response Evaluation Criteria in Solid Tumors (RECIST) version 1.1 criteria., Correlation between TROP2 mRNA baseline levels and changes in CelTIL score at C2D1., Correlation coefficients between TROP2 mRNA and TROP2 IHC biomarkers., Correlation between TROP2 IHC baseline levels and changes in CelTIL score at C2D1., ORR according to TROP2 mRNA expression & TROP2 IHC expression at baseline. CBR according to TROP2 mRNA expression & TROP2 IHC expression at baseline. PFS according to TROP2 mRNA expression & TROP2 IHC expression at baseline. DoR according to TROP2 mRNA expression & TROP2 IHC expression at baseline. TtR according to TROP2 mRNA expression & TROP2 IHC expression at baseline., 1 Correlation of CelTIL score at C2D1 with ORR. 2 Correlation of CelTIL score at C2D1 with CBR. 3 Correlation of CelTIL score at C2D1 with PFS. 4 Correlation of CelTIL score at C2D1 with DoR. 5 Correlation of CelTIL score at C2D1 with TtR., Incidence, seriousness, treatment-related and severity (grade) of Treatment Emergent Adverse Events (TEAEs) assessed by the NCI Common Terminology for Classification of Adverse Events (CTCAE) version 5, including dose reductions, delays and treatment discontinuations.

Source: https://euclinicaltrials.eu/ctis-public/view/2023-505385-28-00